EU clinical trial 2025-524703-76-00: A randomized controlled non-inferiority trial comparing 7 versus 14 days of ciprofloxacin for male urinary tract infections with systemic involvement.
Sponsor: UZ Brussel (Hospital/Clinic/Other health care facility). Phase: Therapeutic confirmatory (Phase III). Countries: Belgium (authorised, recruitment pending).
Therapeutic area(s): Diseases [C] - Bacterial Infections and Mycoses [C01]; Diseases [C] - Male Urogenital Diseases [C12]
Gender: Male. Age: 18-64 years, 65+ years. Enrolment: 264.
Status: Authorised, recruitment pending. Decision date: 2026-05-11. Results received: No. Last updated: 2026-05-12.
Decision dates by country: BE: 2026-05-12

Condition(s): Urinary tract infection with systemic involvement (UTI: definite, probable, or possible UTI according to the diagnostic criteria of the research reference standard for UTI proposed by Bilsen et al (see reference 19 in protocol)). Systemic involvement: one or more of the following, attributable to the UTI: • Temperature ≥38°C; • Flank pain or costovertebral angle tenderness; • Systolic blood pressure <90 mmHg without alternative cause; • Significant elevation of inflammatory markers related to the UTI: o C-reactive protein concentration ≥50 mg/L, Procalcitonin concentration ≥0·5 ng/mL or white blood cell count ≥12×10^9 per L (all without other plausible source, based on at least history and examination). • Bacteraemia with the same pathogen as isolated from urine culture
Product: Microcristalline cellulose placebo identical to over-encapsulated ciprofloxacin EG 500 mg, with HPMC capsule, Vcaps plus, size 000, swedish orange, Ciprofloxacine EG 500 mg comprimés pelliculés

Primary endpoint: Clinical cure rate (resolution of systemic signs/symptoms to pre-admission state, no need of new antibiotic treatment), assessed 14 days after completion of antibiotic treatment.
Endpoint(s): Early UTI relapse (new UTI, caused by same uropathogen as index episode) rates: assessed 14 days after completion of treatment, Late UTI relapse rates: assessed 28 days after completion of treatment, Early UTI recurrence rates (new UTI caused by a different uropathogen than that isolated during the index episode): assessed 14 days after completion of treatment, Late UTI recurrence rates: assessed 28 days after completion of treatment, UTI-related mortality rates: assessed 28 days after completion of treatment, Investigational Medical Product-related adverse drug reactions: assessed 14 days after completion of treatment, UTI-related hospital readmission rates: assessed 28 days after completion of treatment

Source: https://euclinicaltrials.eu/ctis-public/view/2025-524703-76-00